EU clinical trial 2023-505616-38-00: A Multicenter, Global, Interventional, Open label Study of Trastuzumab Deruxtecan (T-DXd), an Anti-HER2-Antibody Drug Conjugate (ADC), in Subjects who Have Unresectable and/or Metastatic HER2-low or HER2 Immunohistochemistry (IHC) 0 Breast Cancer (BC) (DESTINY-Breast15)
Protocol code: DS8201-0001-CIS-MA
Sponsor: Daiichi Sankyo Inc. (Pharmaceutical company). Phase: Therapeutic exploratory (Phase II). Countries: Spain (ongoing, recruiting), Belgium (ongoing, recruiting), Ireland (ongoing, recruiting), Italy (ongoing, recruiting), Portugal (ongoing, recruiting), Netherlands (ongoing, recruiting).
Therapeutic area(s): Diseases [C] - Neoplasms [C04]
Gender: Female, Male. Age: 18-64 years, 65+ years. Enrolment: 139.
Status: Ongoing, recruiting. Start date (EU): 2024-09-04. Decision date: 2023-12-04. Results received: No. Last updated: 2026-06-10.
Decision dates by country: NL: 2024-01-08, BE: 2023-12-11, PT: 2023-12-07, IT: 2023-12-11, ES: 2023-12-04, IE: 2023-12-08

Condition(s): Unresectable and/or Metastatic HER2-low or HER2 Immunohistochemistry (IHC) 0 Breast Cancer
Product: DS-8201a

Primary endpoint: The primary efficacy endpoint is Time to Next Treatment - TTNT. Subjects who did not receive any subsequent therapy and are alive at the time of analysis will be censored at the last contact date. In addition to the final analysis, an interim analysis will be performed when 60% of subjects in each cohort have experienced the primary endpoint, TTNT.
Endpoint(s): Real-world PFS (rwPFS) (Progression-free survival), the key secondary endpoint, is defined as the time from the date of first administration of T-DXd to the date of first observed disease progression or death due to any cause. Disease progression will be determined by investigator assessment of tumor scans and using RECIST version 1.1 criteria., Time to treatment discontinuation - TTD is defined as the time interval from the date of first dose of T-DXd to the date of discontinuation of T-DXd or death due to any cause. Subjects who do not discontinue treatment and are alive at the time of the analysis will be censored at their last contact date., A TEAE (treatment-emergent adverse event) is defined as an AE that occurs, having been absent before the first dose of study drug, or has worsened in severity or seriousness after initiating the study drug until 47 days after the last dose of the study drug., The PRO (Patient-reported Outcomes) analyses include the following: • Subjects with changed status (improvement or deterioration) in EORTC questionnaire scales • Time to first and definitive deterioration from baseline in EORTC questionnaire scales • Responses by level of severity from the EQ-5D-5L items • Scores of EORTC questionnaires, EQ-5D-5L index score, and VAS over time and change from baseline • Subjects within each response category for PGI-C, PGI-S, and PGITT, Overall response rate / objective response rate - ORR is defined as the proportion of subjects with a BOR of confirmed CR or confirmed PR according to the investigator and per RECIST version 1.1 criteria.

Source: https://euclinicaltrials.eu/ctis-public/view/2023-505616-38-00